EU clinical trial 2023-508550-25-00: Combination of Talimogene Laherparepvec (modified Herpes Virus) with atezolizumab (monoclonal antibody) in patients with residual breast cancer after conventional chemotherapy during the early stage of the disease.
Sponsor: Solti Group (Pharmaceutical company). Phase: Human Pharmacology (Phase I)- Other. Countries: Spain (ended).
Therapeutic area(s): Diseases [C] - Neoplasms [C04]
Gender: Female. Age: 18-64 years. Enrolment: 30.
Status: Ended. Start date (EU): 2018-12-10. End date (EU): 2025-03-18. Decision date: 2024-04-26. Results received: No. Last updated: 2024-10-15.

Condition(s): Pre and post-menopausal women with resectable primary breast cancer and presence of residual disease after neoadjuvant chemotherapy

Source: https://euclinicaltrials.eu/ctis-public/view/2023-508550-25-00